EU clinical trial 2024-512732-30-00: A Phase 2, Randomized, Double-Blind, Placebo-Controlled, 48-Week, Parallel-Group Study of the Efficacy and Safety of Losmapimod in Treating Subjects with Facioscapulohumeral Muscular Dystrophy (FSHD) with Open-Label Extension (OLE)
Protocol code: FIS-002-2019
Sponsor: Fulcrum Therapeutics Inc. (Pharmaceutical company). Phase: Therapeutic exploratory (Phase II). Countries: Spain (ended), France (ended).
Therapeutic area(s): Diseases [C] - Musculoskeletal Diseases [C05]
Gender: Female, Male. Age: 18-64 years, 65+ years. Enrolment: 11.
Status: Ended. Start date (EU): 2019-12-06. End date (EU): 2024-11-07. End date: 2024-11-08. Decision date: 2024-04-24. Results received: Yes. Last updated: 2024-04-30.
Decision dates by country: FR: 2024-04-30, ES: 2024-04-24

Condition(s): Facioscapulohumeral Muscular Dystrophy 1 (FSHD1)
Product: Losmapimod

Primary endpoint: The primary endpoint of the OLE is the safety and tolerability of long-term treatment of losmapimod based on AEs, clinical laboratory tests, ECGs, vital signs, and physical examination.
Endpoint(s): The secondary endpoint of the OLE is the plasma concentrations of losmapimod after long-term dosing (at every-12-week time points).

Source: https://euclinicaltrials.eu/ctis-public/view/2024-512732-30-00